EU clinical trial 2024-514052-32-00: Phase Ib, non-randomized, single-arm, open-label, single-center clinical trial to evaluate the safety of the first-in-human administration of the combination of dendritic cell (DC) immunization pulsed with tumor lysate and CAR-T cells targeting IL13Ra2 in patients with newly diagnosed diffuse intrinsic pontine glioma (DIPG)
Protocol code: FSJD-DIPG-DC-CART
Sponsor: Fundacio Sant Joan De Deu (Patient organisation/association). Phase: Human Pharmacology (Phase I)- First administration to humans. Countries: Spain (authorised, recruitment pending).
Therapeutic area(s): Diseases [C] - Neoplasms [C04]
Gender: Female, Male. Age: 0-17 years, 18-64 years. Enrolment: 15.
Status: Authorised, recruitment pending. Decision date: 2025-12-22. Results received: No. Last updated: 2026-07-27.

Condition(s): Patients with newly diagnosed diffuse intrinsic pontine glioma (DIPG)
Product: DIPG-DC, DIPG-lysate, ARI0008

Primary endpoint: Number of Grade 3–4 serious adverse events (SAEs) according to Common Toxicity Criteria (CTC) from the start of treatment (first administration of DCs) until the end of the study per patient.
Endpoint(s): Proportion of patients with adverse events (AEs) and serious adverse events (SAEs), as well as the proportion of patients who discontinue treatment due to AEs., Percentage of patients receiving the full treatment regimen, defined as the complete administration of both DCs and CAR-T cells., Evaluation of immunological parameters according to the study schedule., Overall survival (OS) and progression-free survival (PFS) in DIPG patients treated with the proposed regimen. A comparison will be made with historical controls from the institution (HSJD) and other international institutions (COG and SIOP)., Evaluation of radiological changes following RAPNO criteria (see Annex 3: Criteria for Radiological and Clinical Response Assessment)., Evaluation of the distribution of anti-IL13Ra2 CAR-T cells in CSF, peripheral blood, and, if available, tumour samples, according to the study schedule., Correlation between histological and molecular characterisation, clinical-radiological response, and cellular response generated in peripheral blood and CSF following treatment., Correlation between immunological response and clinical progression. Determination of whether cellular response in peripheral blood and CSF correlates with increased overall survival and progression-free survival., Evaluation of performance (QoL) as an indicator of quality of life. QoL will be assessed through prospective evaluation of each patient’s functionality using the PedsQL questionnaire (see Annex 2: Neurological and Functional Assessment).

Source: https://euclinicaltrials.eu/ctis-public/view/2024-514052-32-00